EU clinical trial 2024-519318-30-00: Phase I, Open-label, Single-center, Dose Escalation Study to Assess Safety and Tolerability of anti-CD19 CAR-T Cells in Patients with B-cell non-Hodgkin Lymphomas (CARMEN).
Protocol code: 2020/ABM/01/00107
Sponsor: Wroclaw Medical University (Educational Institution). Phase: Human Pharmacology (Phase I)- First administration to humans. Countries: Poland (ongoing, recruiting).
Therapeutic area(s): Diseases [C] - Hemic and Lymphatic Diseases [C15]; Diseases [C] - Neoplasms [C04]
Gender: Female, Male. Age: 18-64 years, 65+ years. Enrolment: 18.
Status: Ongoing, recruiting. Start date (EU): 2025-06-25. Decision date: 2025-03-27. Results received: No. Last updated: 2026-03-13.

Condition(s): non-Hodgkin Lymphomas; Subtypes: DLBCL - ORPHA: 544; Agressive B-cell non-Hodgkin lymphoma ORPHA: 300846 High grade B-cell lymphoma with MYCand/or BCL2 and/or BCL6 rearrangement ORPHA: 480541

Source: https://euclinicaltrials.eu/ctis-public/view/2024-519318-30-00